EU clinical trial 2025-523826-41-00: A Phase 1 first-in-human study to evaluate SAR447754 in healthy adult participants and in adult participants with moderate-to-severe atopic dermatitis.
Protocol code: SAD18615-MAD18616
Sponsor: Sanofi-Aventis Recherche & Developpement (Pharmaceutical company). Phase: Human Pharmacology (Phase I)- First administration to humans. Countries: Belgium (ongoing, recruiting), Hungary (authorised, recruitment pending), Spain (authorised, recruitment pending).
Therapeutic area(s): Diseases [C] - Immune System Diseases [C20]
Gender: Female, Male. Age: 18-64 years. Enrolment: 241.
Start date (EU): 2026-02-25. Decision date: 2026-02-16. Results received: No. Last updated: 2026-08-04.
Decision dates by country: HU: 2026-07-17, ES: 2026-08-04, BE: 2026-02-16

Condition(s): Dermatitis atopic

Source: https://euclinicaltrials.eu/ctis-public/view/2025-523826-41-00